EU clinical trial 2024-512330-15-00: Phase I, first-in-man, randomised, placebo-controlled, single dose escalation study to investigate the effects of LPH-5 on safety, tolerability, pharmacokinetic and pharmacodynamic parameters in healthy participants
Protocol code: LPH-5CS01
Sponsor: Lophora ApS (Pharmaceutical company). Phase: Human Pharmacology (Phase I)- First administration to humans. Countries: France (ended).
Therapeutic area(s): Psychiatry and Psychology [F] - Mental Disorders [F03]
Gender: Female, Male. Age: 18-64 years, 65+ years. Enrolment: 56.
Status: Ended. Start date (EU): 2025-08-05. End date (EU): 2025-12-23. Decision date: 2024-09-13. Results received: No. Last updated: 2025-08-01.

Condition(s): Depression

Source: https://euclinicaltrials.eu/ctis-public/view/2024-512330-15-00